EU clinical trial 2024-516834-36-00: A Phase 3, Randomized, Open-label Study Comparing Efficacy and Safety of Sacituzumab Tirumotecan (sac-TMT, MK-2870) as a Monotherapy and in Combination with Pembrolizumab (MK-3475) Versus Treatment of Physician’s Choice in Participants With Previously Untreated Locally Recurrent Unresectable or Metastatic Triple-Negative Breast Cancer Expressing PD-L1 at CPS Less than 10 (TroFuse-011)
Protocol code: MK-2870-011
Sponsor: Merck Sharp & Dohme LLC (Pharmaceutical company). Phase: Therapeutic confirmatory (Phase III). Countries: Netherlands (ongoing, recruiting), Poland (ongoing, recruiting), Romania (ongoing, recruiting), Spain (ongoing, recruiting), France (ongoing, recruiting), Belgium (ongoing, recruiting), Czechia (ongoing, recruiting), Germany (ongoing, recruiting), Denmark (ongoing, recruiting), Finland (ongoing, recruiting), Greece (ongoing, recruiting), Hungary (ongoing, recruiting), Italy (ongoing, recruiting).
Therapeutic area(s): Diseases [C] - Neoplasms [C04]
Gender: Female, Male. Age: 18-64 years, 65+ years. Enrolment: 320.
Status: Ongoing, recruiting. Start date (EU): 2025-07-08. Decision date: 2025-07-04. Results received: No. Last updated: 2026-04-20.
Decision dates by country: RO: 2025-07-07, ES: 2025-07-04, DK: 2025-09-26, DE: 2025-09-19, GR: 2025-08-20, BE: 2025-07-04, PL: 2025-07-07, NL: 2025-07-07, IT: 2025-08-29, FR: 2025-07-24, FI: 2025-09-23, CZ: 2025-10-02, HU: 2025-10-01

Condition(s): Locally recurrent unresectable or metastatic TNBC with tumors expressing PD-L1 at the cut-off of CPS <10
Product: MK-2870, GEMCITABINE, KEYTRUDA 25 mg/mL concentrate for solution for infusion, CARBOPLATIN, PACLITAXEL ALBUMIN-BOUND, PACLITAXEL

Primary endpoint: Progression-Free Survival (PFS) (sac-TMT versus treatment of physician's choice (TPC); sac-TMT plus pembrolizumab versus TPC), Overall Survival (OS) (sac-TMT versus TPC)
Endpoint(s): Overall Survival (OS) (sac-TMT plus pembrolizumab versus treatment of physician's choice (TPC); sac-TMT plus pembrolizumab versus sac-TMT), Progression-Free Survival (PFS) (sac-TMT plus pembrolizumab versus sac-TMT), Objective Response Rate (ORR) (sac-TMT versus TPC; sac-TMT plus pembrolizumab versus TPC), Duration of Response (DOR), Change from baseline in global health status/quality of life scores, on the European Organization for the Research and Treatment of Cancer Quality of Life Questionnaire Core 30 (EORTC QLQ-C30) (sac-TMT versus TPC; sac-TMT plus pembrolizumab versus TPC), Change from baseline in physical functioning score, on the EORTC QLQ-C30 (sac-TMT versus TPC; sac-TMT plus pembrolizumab versus TPC), Change from baseline in emotional functioning score, on the EORTC QLQ-C30 (sac-TMT versus TPC; sac-TMT plus pembrolizumab versus TPC), Change from baseline in fatigue score, on the EORTC QLQ-C30 (sac-TMT versus TPC; sac-TMT plus pembrolizumab versus TPC), Change from baseline in diarrhea score, on the EORTC QLQ-C30 (sac-TMT versus TPC; sac-TMT plus pembrolizumab versus TPC), Number of participants who experience one or more adverse events (AEs), Number of participants who discontinue study treatment due to an AE

Source: https://euclinicaltrials.eu/ctis-public/view/2024-516834-36-00